EU clinical trial 2022-501538-44-00: A Phase 3, Randomized, 24-week, Placebo-controlled, Double-blind Study to Assess the Efficacy, Safety and Tolerability of Rocatinlimab (AMG 451) Monotherapy in Adult Subjects With Moderate-to-severe Atopic Dermatitis (AD) (ROCKET-Horizon)
Protocol code: 20210143
Sponsor: Amgen Inc. (Pharmaceutical company). Phase: Therapeutic confirmatory (Phase III). Countries: Poland (ended), Estonia (ended), Denmark (ended), Portugal (ended), Romania (ended), Finland (ended), Sweden (ended), Germany (ended), Belgium (ended), Czechia (ended), Spain (ended).
Therapeutic area(s): Diseases [C] - Immune System Diseases [C20]
Gender: Female, Male. Age: 18-64 years, 65+ years. Enrolment: 234.
Status: Ended. Start date (EU): 2023-04-25. End date (EU): 2025-06-17. End date: 2025-06-18. Decision date: 2023-03-28. Results received: Yes. Last updated: 2025-06-17.
Decision dates by country: DK: 2023-03-28, RO: 2023-04-03, EE: 2023-04-03, FI: 2023-04-18, PL: 2023-04-03, SE: 2023-04-18, ES: 2023-04-18, BE: 2023-04-18, DE: 2023-04-18, PT: 2023-03-29, CZ: 2023-04-18

Condition(s): Atopic Dermatitis
Product: Rocatinlimab, Placebo for AMG 451

Primary endpoint: Whether or not a participant has a clear or almost clear skin at week 24 based on vIGA-AD., Whether or not a participant’s eczema is at least 75% better at week 24 compared to the start of the study based on EASI.
Endpoint(s): Whether or not a participant’s eczema has achieved certain improvement as compared to the start of the study based on EASI, Whether or not a participant has a clear or almost clear skin at week 16 based on vIGA-AD, Whether or not a participant has less skin itching at week 16 compared to the start of the study based on the participant’s daily scoring. Whether or not a participant has less skin itching at week 24 compared to the start of the study based on the participant’s daily scoring, Whether or not a participant’s eczema has achieved certain improvement at week 24 compared to the start of the study based on EASI, Whether or not a participant has less ezcema skin pain at week 24 compared to the start of the study based on participant's weekly scoring, Whether or not a participant has almost clear skin or almost clear skin with at most slight redness or clear skin at week 24, Whether or not a participant has an overall clear skin on the face at week 24., Whether or not a participant has an overall clear skin on the hand at week 24., A participant’s quality of life at week 24 compared to the start of the study while having eczema based on DLQI. DLQI measures how a participant feels about the quality of life because of skin diseases

Source: https://euclinicaltrials.eu/ctis-public/view/2022-501538-44-00